EU clinical trial 2023-505601-16-00: C4951013 - AN INTERVENTIONAL, EFFICACY, AND SAFETY, PHASE 3 RANDOMIZED, DOUBLE-BLIND, PLACEBO-CONTROLLED STUDY WITH AN OPEN-LABEL EXTENSION TO INVESTIGATE RIMEGEPANT IN MIGRAINE PREVENTION IN ADOLESCENTS 12 TO LESS THAN 18 YEARS OF AGE WITH CHRONIC MIGRAINE
Protocol code: C4951013
Sponsor: Pfizer Inc. (Pharmaceutical company). Phase: Therapeutic confirmatory (Phase III). Countries: Hungary (ongoing, recruitment ended), Italy (ongoing, recruitment ended), Spain (ongoing, recruitment ended), Czechia (ongoing, recruitment ended), Poland (ongoing, recruitment ended), Finland (ongoing, recruitment ended), Slovakia (ongoing, recruitment ended).
Therapeutic area(s): Diseases [C] - Nervous System Diseases [C10]
Gender: Female, Male. Age: 0-17 years. Enrolment: 80.
Status: Ongoing, recruitment ended. Start date (EU): 2025-04-22. Decision date: 2024-10-18. Results received: No. Last updated: 2026-07-10.
Decision dates by country: SK: 2024-10-23, IT: 2024-10-18, FI: 2024-10-21, ES: 2024-10-21, PL: 2024-10-22, HU: 2024-10-22, CZ: 2024-10-21

Condition(s): Chronic Migraine
Product: Placebo to rimegepant sulfate, RIMEGEPANT SULFATE

Primary endpoint: Mean change from the observation phase (OP) in the number of migraine days per month over the entire double-blind treatment (DBT) Phase (Weeks 1 to 12).
Endpoint(s): Mean change from the OP in the number of acute migraine-specific medication days per month over the entire DBT Phase (Weeks 1 to 12)., Mean change from the OP in the number of moderate or severe headache days per month over the entire DBT Phase (Weeks 1 to 12)., Percentage of participants with ≥50% reduction from the OP in the number of moderate or severe migraine days per month over the entire DBT Phase (Weeks 1 to 12)., Mean change from baseline in the PedsQL™ 4.0 Generic Core Scales total score at Week 12 of the DBT Phase., Mean change from the OP in the number of acute headache medication days per month and acute migraine-specific medicationdays per month in each month and over the entire DBT Phase., The number and percentage of participants with adverse events (AEs), serious adverse events (SAEs), AEs leading to study intervention discontinuation and grade 3 to 4 laboratory test abnormalities on treatment during the DBT and open-label extension (OLE) Phases., The number and percentage of participants with hepatic-relate AEs and hepatic-related AEs leading to study intervention discontinuation on treatment during the DBT and OLE Phases., Mean change from baseline in the PedMIDAS total score at Week 12 of the DBT Phase.

Source: https://euclinicaltrials.eu/ctis-public/view/2023-505601-16-00